EU clinical trial 2024-514598-23-00: Safety and efficacy of IMM-101 combined with stereotactic radiotherapy in patients with limited metastatic pancreatic cancer (MEPANC-1)
Sponsor: Erasmus Universitair Medisch Centrum Rotterdam (Erasmus MC) (Hospital/Clinic/Other health care facility). Phase: Phase I and Phase II (Integrated)- Other. Countries: Netherlands (ended).
Therapeutic area(s): Diseases [C] - Neoplasms [C04]
Gender: Female, Male. Age: 18-64 years, 65+ years. Enrolment: 100.
Status: Ended. Start date (EU): 2021-02-09. End date (EU): 2024-10-15. Decision date: 2024-08-13. Results received: Yes. Last updated: 2024-08-13.

Condition(s): Limited metastatic pancreatic cancer

Primary endpoint: The main endpoint of the first inclusion phase is to determine safety/toxicity of IMM- 101 and SBRT administration in patients with limited metastatic pancreatic cancer., The main endpoint of the second inclusion phase is to asses efficacy of IMM-101 therapy in combination with SBRT in patients with limited metastatic pancreatic cancer.
Endpoint(s): Overall survival will be calculated from the start of FOLFIRINOX treatment to death (OS1)., Overall survival will be calculated from the start of IMM-101 treatment to death (OS2)., Progression free survival will be calculated from the start of IMM-101 treatment to the date of progressive disease of the primary tumour or locoregional recurrence, progression of previously treated lungs and/or liver metastasis, the occurrence of new metastases or death (PFS2)., Quality of life. Scoring procedures for the EORTC QLQ-c30 will be varied out according to the corresponding manual. Scores between baseline and week 8 will be compared by using the paired t-test for normally distributed data while the Wilcoxon signed rank test will be used for non-normally distributed data. For visualization, box plots will be generated., Radiological response rate after IMM-101 and SBRT using iRECIST criteria., Radiological response rate after IMM-101 and SBRT using RECIST criteria (version 1.1)., Safety/Toxicity according to CTCAE 5.0., Effect on circulating immune cells: pre-treatment (week 0), during treatment (week 2,4,8) and post treatment (week 26) venous blood will be monitored for the frequency and activation state of T cells, NKs, and myeloid subsets and for WT-1 and mesothelin specific T cell responses by flow cytometry and Elispot read-out; inflammatory and suppressive cytokine levels will be assessed in plasma., Tumour-specific immune and tumour marker responses. Pre- and 2x post-treatment CA19.9 and CEA levels will be assessed on blood samples.

Source: https://euclinicaltrials.eu/ctis-public/view/2024-514598-23-00